EU clinical trial 2024-518833-27-00: A Study Evaluating the Pharmacokinetics of Three QRL-101 Formulations in Healthy Participants
Protocol code: QRL-101-06
Sponsor: Quralis Corp. (Pharmaceutical company). Phase: Human Pharmacology (Phase I)- Other. Countries: Netherlands (ended).
Therapeutic area(s): Diseases [C] - Nervous System Diseases [C10]
Gender: Female, Male. Age: 18-64 years, 65+ years. Enrolment: 24.
Status: Ended. Start date (EU): 2025-01-10. End date (EU): 2025-05-15. Decision date: 2024-12-19. Results received: No. Last updated: 2025-05-28.

Condition(s): Amyotrophic Lateral Sclerosis (ALS)

Source: https://euclinicaltrials.eu/ctis-public/view/2024-518833-27-00